EU clinical trial 2024-511170-69-00: Phase 1 Two-Part (Open-label, Single Ascending Dose (Part 1) and Open-label, Single Dose Expansion (Part 2)) Study to Evaluate Safety, Tolerability, Pharmacokinetics, and Pharmacodynamics of NTLA-2001 in Patients With Hereditary Transthyretin Amyloidosis With Polyneuropathy (ATTRv-PN).
Protocol code: ITL-2001-CL-001
Sponsor: Intellia Therapeutics Inc. (Pharmaceutical company). Phase: Human Pharmacology (Phase I)- First administration to humans. Countries: France (ended), Sweden (ended).
Therapeutic area(s): Diseases [C] - Congenital, Hereditary, and Neonatal Diseases and Abnormalities [C16]
Gender: Female, Male. Age: 18-64 years, 65+ years. Enrolment: 15.
Status: Ended. Start date (EU): 2021-08-17. End date (EU): 2025-04-09. End date: 2025-09-12. Decision date: 2024-08-14. Results received: No. Last updated: 2025-07-11.
Decision dates by country: SE: 2024-08-14, FR: 2024-08-20

Condition(s): Hereditary Transthyretin Amyloidosis with Polyneuropathy (ATTRv-PN)
Product: NTLA-2001

Primary endpoint: Safety assessments, immunogenicity assessments, pharmacokinetic assessments, pharmacodynamic assessments
Endpoint(s): Polyneuropathy assessments

Source: https://euclinicaltrials.eu/ctis-public/view/2024-511170-69-00